EU clinical trial 2023-506509-21-00: A Phase 1b, Open-Label, Multiple Ascending Dose, Multicenter Study of VRG50635 in Participants With Sporadic and Familial Amyotrophic Lateral Sclerosis Followed by Long-Term Treatment
Protocol code: VGCS-50635-002
Sponsor: Verge Genomics (Pharmaceutical company). Phase: Human Pharmacology (Phase I)- Other. Countries: Finland (ended), Belgium (ended), Netherlands (ended), Spain (ended), Sweden (not authorised).
Therapeutic area(s): Diseases [C] - Nervous System Diseases [C10]
Gender: Female, Male. Age: 18-64 years, 65+ years. Enrolment: 47.
Status: Ended. Start date (EU): 2024-03-08. End date (EU): 2025-08-04. End date: 2025-08-05. Decision date: 2024-01-22. Results received: No. Last updated: 2025-07-14.
Decision dates by country: SE: 2024-01-26, ES: 2024-02-28, NL: 2024-02-13, BE: 2024-03-11, FI: 2024-03-11

Condition(s): Amyotrophic Lateral Sclerosis

Source: https://euclinicaltrials.eu/ctis-public/view/2023-506509-21-00